EU clinical trial 2024-512673-28-00: Double-blind placebo-controlled cross-over MRI study to evaluate the effect of naloxegol and codeine on gastrointestinal motility and volumes
Sponsor: UZ Leuven (Hospital/Clinic/Other health care facility). Phase: Therapeutic use (Phase IV). Countries: Belgium (ended).
Therapeutic area(s): Diseases [C] - Digestive System Diseases [C06]
Gender: Female, Male. Age: 18-64 years. Enrolment: 15.
Status: Ended. Start date (EU): 2024-10-28. End date (EU): 2025-07-03. Decision date: 2024-09-16. Results received: Yes. Last updated: 2024-09-16.

Condition(s): Opioid-induced constipation
Product: Lactose monohydrate 320mg tablet, once orally, for 2 study visits, NALOXEGOL, BISACODYL, Sirupus simplex 30mL followed by 15mL after two hours, at one study visit, BRONCHODINE 10mg/5ml siroop

Primary endpoint: investigation of the effect of the 3 drug-arms (placebo+placebo, naloxegol+codeine, placebo+codeine) on both colonic motility and segmental colorectal volumes at baseline, after an oat porridge meal and after bisacodyl administration

Source: https://euclinicaltrials.eu/ctis-public/view/2024-512673-28-00